EU clinical trial 2023-507506-14-01: Comparison of PENG block and lumbar plexus block in terms of postoperative analgesia and mobilization for fast track primary hip arthroplasty
Protocol code: fastpeng
Sponsor: Hospital Del Mar (Hospital/Clinic/Other health care facility). Phase: Therapeutic use (Phase IV). Countries: Spain (ongoing, recruiting).
Therapeutic area(s): Diseases [C] - Musculoskeletal Diseases [C05]
Gender: Female, Male. Age: 18-64 years, 65+ years. Enrolment: 64.
Status: Ongoing, recruiting. Start date (EU): 2024-05-08. Decision date: 2024-03-15. Results received: No. Last updated: 2024-07-04.

Condition(s): Total Hip Arthroplasty
Product: Suero Fisiológico Braun 0,9% disolvente para uso parenteral Cloruro de sodio, Levobupivacaína Altan 2,5 mg/ml solución inyectable y para perfusión EFG

Primary endpoint: Pain, Quadriceps muscular strength
Endpoint(s): Adverse effects: Nausea, vomiting, sedation, toxicity, others, Opioid consumption, Need for additional analgesia, Length of hospital stay, Pain experience

Source: https://euclinicaltrials.eu/ctis-public/view/2023-507506-14-01